EU clinical trial 2024-515056-20-00: Dual Antithrombotic Therapy with Dabigatran and Ticagrelor in Patients with Acute Coronary Syndrome and Non-valvular Atrial Fibrillation Undergoing Percutaneous Coronary Intervention (ADONIS-PCI)
Protocol code: NBK182/1/2020
Sponsor: Medical University Of Gdansk (Educational Institution). Phase: Therapeutic confirmatory (Phase III). Countries: Poland (ended).
Therapeutic area(s): Diseases [C] - Cardiovascular Diseases [C14]
Gender: Female, Male. Age: 18-64 years, 65+ years. Enrolment: 2230.
Status: Ended. Start date (EU): 2021-07-31. End date (EU): 2025-10-31. Decision date: 2024-11-24. Results received: No. Last updated: 2025-04-01.

Condition(s): Acute Coronary Syndrome and Non-valvular Atrial Fibrillation Undergoing Percutaneous Coronary Intervention
Product: Brilique 60 mg film-coated tablets, Brilique 90 mg film-coated tablets

Primary endpoint: First major or clinically relevant non-major bleeding event (ISTH)
Endpoint(s): Composite of thromboembolic events (MI, stroke, systemic embolism) or death or unplanned revascularization (PCI or CABG)

Source: https://euclinicaltrials.eu/ctis-public/view/2024-515056-20-00